EU clinical trial 2025-524408-30-01: Phase III Randomized, International, Open-Label Clinical Trial of Treatment Intensification with Docetaxel plus Apalutamide in Patients with Metastatic Hormone-Sensitive Prostate Cancer Who Did Not Achieve a Deep PSA Response After Initial Treatment with Apalutamide: REINFORCE Trial
Protocol code: REINFORCE
Sponsor: Alianza Multidisciplinar Para La Investigacion De Los Tumores Genitourinarios Guard (Patient organisation/association). Phase: Therapeutic confirmatory (Phase III). Countries: Spain (ongoing, recruiting), Germany (authorised, recruitment pending), France (authorised, recruitment pending), Portugal (authorised, recruitment pending), Italy (authorised, recruitment pending).
Therapeutic area(s): Diseases [C] - Neoplasms [C04]
Gender: Male. Age: 18-64 years, 65+ years. Enrolment: 292.
Start date (EU): 2026-06-05. Decision date: 2026-05-19. Results received: No. Last updated: 2026-08-07.
Decision dates by country: DE: 2026-05-21, FR: 2026-05-19, ES: 2026-05-19, PT: 2026-05-20, IT: 2026-06-08

Condition(s): Metastatic hormone-sensitive prostate cancer
Product: Docetaxel AqVida 20 mg/ml Konzentrat zur Herstellung einer Infusionslösung, Erleada 240 mg film-coated tablets, Erleada 60 mg film-coated tablets

Primary endpoint: Event-free Survival (EFS)
Endpoint(s): Time to castration resistance, Radiographic progression-free survival (rPFS), PSA progression-free survival, Overall survival, Time to subsequent treatment, Symptomatic skeletal event free survival, Deep and/or ultradeep PSA response rate at 6 months, Time to initiate opioid use (≥ 7 days), Adverse events, serious adverse events, adverse events leading to treatment discontinuation and death., Change from baseline over time in each of the subscales of FACT-P, BPI-SF interference subscale and BFI .

Source: https://euclinicaltrials.eu/ctis-public/view/2025-524408-30-01